EU clinical trial 2024-513371-41-00: UVB : Multicenter, randomized, prospective trial comparing the Efficacy and Safety of Adalimumab to that of Tocilizumab in severe uveitis of Behçet’s disease
Protocol code: APHP200007
Sponsor: Assistance Publique Hopitaux De Paris (Hospital/Clinic/Other health care facility). Phase: Therapeutic exploratory (Phase II). Countries: France (ongoing, recruiting).
Therapeutic area(s): Diseases [C] - Eye Diseases [C11]; Diseases [C] - Skin and Connective Tissue Diseases [C17]
Gender: Female, Male. Age: 18-64 years, 65+ years. Enrolment: 60.
Status: Ongoing, recruiting. Start date (EU): 2024-04-25. Decision date: 2024-08-27. Results received: No. Last updated: 2025-07-11.

Condition(s): Severe uveitis of Behçet’s disease
Product: RoActemra 162 mg solution for injection in pre-filled syringe., Humira 80 mg solution for injection in pre-filled pen

Primary endpoint: Efficacy will be defined by a complete remission of ocular involvement with prednisone (or prednisolone, only if prednisone is out of stock in the market) lower or equal to 5 mg/day at W16 after randomization. Complete remission of ocular inflammation will be defined as complete resolution of retinal vasculitis and/or macular edema with prednisone (or prednisolone, only if prednisone is out of stock) lower or equal to 5 mg/day at W16. In patients with bilateral uveit
Endpoint(s): Measures of corticosteroid sparing (e.g., percent meeting targets [lower than 0.1 mg/day/kg of prednisone (or prednisolone, only if prednisone is out of stock in the market)], mean dose at week 16, and cumulative dose)., Time to response onset, Measures of acute-phase reactants (erythrocyte sedimentation rate [ESR], C-reactive protein [CRP], at week 4, 8, 12, 16, 24, 36 and 48, Rate and Time to occurrence of relapse or worsening while on study. (Relapse will be defined as the reappearance of clinical and/or paraclinical features of active disease or by the occurrence of new lesions or progression of preexisting lesions)., Changes in Behcet’s Disease Current Activity Form (BDCA) at week 8, 16 and 24, Changes in Behcet’s Syndrome Activity Score (BSAS) at week 16, Changes in other organs involved by BD at week 4, 8, 12, 16, 24, 36 and 48, Changes in quality of life (QOL) (SF36v2 TM Health Survey) and Behcet’s Disease Quality of Life Measure (BD-QoL) at week 16 and 24, Safety and tolerability of treatments in BD patients as assessed by frequency and severity of adverse clinical events at week 4, 8, 12, 16, 24, 36 and 48, Time to treatment failure (time to occurence), Changes in Tyndall, flare and Vitreous Haze at week 8, 16, 24, 36 and 48, Changes in Best corrected visual acuity (SNELLEN score) at week 8, 16, 24, 36 and 48, Changes in central retinal thickness measured with Optical Coherence Tomography (OCT) at week 8, 16, 24, 36 and 48, Percentage of patients with central retinal thickness <300 microns at week 8, 16, 24, 36 and 48, Percentage of patients without retinal vessel leakage on retinal angiography at week 16, and at week 24, 36 and 48, in case of retinal vasculitis

Source: https://euclinicaltrials.eu/ctis-public/view/2024-513371-41-00